EU clinical trial 2025-524498-17-00: A two-part, seamless, multicenter, RANDOMIZED, open-label, ADAPTIVE Phase ii/III STUDY OF THE BLOOD-BRAIN barrier PENETRANT RO7771950 versus Tucatinib, both in combination with trastuzumab and capecitabine, in patients with Pretreated unresectable locally advanced or metastatic HER2-positive breast cancer, with or without central nervous system metastases
Protocol code: WO46069
Sponsor: F. Hoffmann-La Roche AG (Pharmaceutical company). Phase: Phase II and Phase III (Integrated). Countries: Belgium (authorised, recruiting), France (authorised, recruitment pending), Italy (ongoing, recruiting), Austria (authorised, recruiting), Romania (authorised, recruitment pending), Poland (ongoing, recruiting), Portugal (ongoing, recruiting), Czechia (authorised, recruiting), Germany (authorised, recruiting), Spain (ongoing, recruiting), Hungary (ongoing, recruiting).
Therapeutic area(s): Diseases [C] - Neoplasms [C04]
Gender: Female, Male. Age: 18-64 years, 65+ years. Enrolment: 237.
Start date (EU): 2026-05-08. Decision date: 2026-04-28. Results received: No. Last updated: 2026-05-22.
Decision dates by country: AT: 2026-04-30, BE: 2026-04-28, CZ: 2026-04-29, FR: 2026-05-04, HU: 2026-05-04, IT: 2026-04-29, PT: 2026-05-04, RO: 2026-05-04, ES: 2026-05-04, PL: 2026-04-30, DE: 2026-04-29

Condition(s): Pretreated Unresectable Locally Advanced or Metastatic human epidermal growth factor receptor 2 (HER2)-Positive Breast Cancer, with or without Central Nervous System (CNS) Metastases
Product: TUCATINIB, CAPECITABINE, TUCATINIB, RO7771950, RO7771950, TRASTUZUMAB, CAPECITABINE, TRASTUZUMAB

Primary endpoint: Progression-Free Survival in Full Analysis Set (PFS-FAS)
Endpoint(s): Progression-Free Survival in participants with CNS metastases (PFS-CNS), Overall Survival in Full Analysis Set (OS-FAS), Objective Response Rate (ORR), Duration Of Response (DOR), Clinical Benefit Rate (CBR), Objective Response Rate in participants with CNS metastases (ORR-CNS), Duration Of Response in participants with CNS metastases (DOR-CNS), Clinical Benefit Rate in participants with CNS metastases (CBR-CNS), Mean and mean changes from baseline score in symptoms experienced by participants with brain tumors, as measured by the European Organisation for Research and Treatment of Cancer Quality of Life Questionnaire - Brain Neoplasm module (EORTC QLQ-BN20), Mean and mean changes from baseline score in function (role, physical, cognitive, social, emotional) and HRQoL by cycle and between treatment arms as measured by the EORTC QLQ-C30, Incidence and severity of adverse events, with severity determined according to National Cancer Institute Common Terminology Criteria for Adverse Events Version 5.0 (NCI CTCAE v5.0), Change from baseline in selected clinical laboratory test results, vital signs, echocardiogram/multiple-gated acquisition (ECHO/MUGA), Electrocardiogram (ECG), and Columbia Suicide Severity Rating Scale (C-SSRS), Presence, frequency of occurrence, severity, and/or degree of interference with daily activities of symptomatic treatment toxicities (i.e., PPE, mouth/throat sores, nausea, vomiting, diarrhea, headache, rash, abdominal pain, decreased appetite, fatigue) as assessed through use of the patient-reported outcome - Common Terminology Criteria for Adverse Events (PRO-CTCAE), Proportion of participants reporting each response option at each assessment timepoint by treatment arm for treatment side-effect bother single-item Functional Assessment of Cancer Therapy (FACT-GP5), Change from baseline/worsening in symptomatic treatment toxicities (PRO-CTCAE) and treatment side-effect bother FACT-GP5, Health utility scores of the European Quality of Life 5 Dimensions 5 Level Version (EQ-5D-5L), Plasma concentration of RO7771950 and its metabolite(s) at specified timepoints

Source: https://euclinicaltrials.eu/ctis-public/view/2025-524498-17-00